EU clinical trial 2024-514316-27-00: The impact of PDD during TURB for NMIBC: a prospective randomized controlled trial
Protocol code: CDS01FS
Sponsor: Azienda Ospedaliera Universitaria Citta Della Salute E Della Scienza Di Torino (Hospital/Clinic/Other health care facility). Phase: Therapeutic use (Phase IV). Countries: Italy (authorised, recruitment pending).
Therapeutic area(s): Diseases [C] - Male Urogenital Diseases [C12]; Diseases [C] - Neoplasms [C04]
Gender: Female, Male. Age: 18-64 years, 65+ years. Enrolment: 300.
Status: Authorised, recruitment pending. Decision date: 2025-05-19. Results received: No. Last updated: 2025-05-19.

Condition(s): Not muscular invasive bladder cancer
Product: Hexvix 85 mg polvere e solvente per soluzione endovescicale

Primary endpoint: proportion of patients with residual tumour and/or new diagnosis of CIS at the time of reTUR (persistent CIS diagnosed at primary TUR will not count as residual tumour) in comparison between PDD and WLC
Endpoint(s): proportion of CIS and upstaging according to the definition by Lamm et al. at re-TUR, comparative 3-months recurrence rate for patients not undergoing reTUR., proportion of malignant lesions at primary TURB and re-TURB between PDD and WLC utilising high-definition equipment., Proportion of patients with treatment change as a result of additional tumour findings at re-TUR., Quality of life estimated with EQ5DL and the QLQ-NMIBC24 questionnaires performed at the following timepoints: after randomization, 1 month after 1st TURB, 3 months after Re-TURBT for all groups, Adverse events

Source: https://euclinicaltrials.eu/ctis-public/view/2024-514316-27-00